EU clinical trial 2022-503146-53-00: A study in women with overweight or obesity to test whether different doses of BI 456906 influence the amount of a contraceptive in the blood
Protocol code: 1404-0014
Sponsor: Boehringer Ingelheim International GmbH (Pharmaceutical company). Phase: Human Pharmacology (Phase I)- Other. Countries: Germany (ended).
Therapeutic area(s): Diseases [C] - Nutritional and Metabolic Diseases [C18]
Gender: Female. Age: 18-64 years. Enrolment: 24.
Status: Ended. Start date (EU): 2023-12-07. End date (EU): 2025-03-26. Decision date: 2023-08-16. Results received: No. Last updated: 2025-02-26.

Condition(s): pharmacokinetic trial

Source: https://euclinicaltrials.eu/ctis-public/view/2022-503146-53-00